EU clinical trial 2023-504925-38-00: Phase II study evaluating the addition of elacestrant, an oral selective estrogen receptor degrader (SERD), to standard-of-care olaparib in patients with hormone receptor (HR)-positive, HER2-negative locally advanced or metastatic breast cancer with gBRCA1/2 mutations – ELEMENT
Protocol code: GBG 114
Sponsor: GBG Forschungs GmbH (Hospital/Clinic/Other health care facility). Phase: Therapeutic exploratory (Phase II). Countries: Germany (ongoing, recruiting).
Therapeutic area(s): Diseases [C] - Neoplasms [C04]
Gender: Female, Male. Age: 18-64 years, 65+ years. Enrolment: 176.
Status: Ongoing, recruiting. Start date (EU): 2024-12-10. Decision date: 2024-03-14. Results received: No. Last updated: 2026-07-09.

Condition(s): patients with hormone receptor (HR)-positive, HER2-negative locally advanced or metastatic breast cancer with gBRCA1/2 mutations
Product: Elacestrant, Elacestrant, Lynparza 150 mg film-coated tablets

Primary endpoint: PFS is defined as the time from randomization to first progression as assessed by the investigator, or death, whichever occurs first. Patients lost to follow up or progression-free at the end of the study will be censored at the date of last contact.
Endpoint(s): TTF is defined as time from randomization to discontinuation of treatment due to disease progression, treatment toxicity, patient´s preference, or death. Patients lost to follow up or still under treatment at the end of the study will be censored at the date of last contact., OS is defined as the time from randomization to death due to any reason. Patients lost to follow up or alive at the end of the study will be censored at the date of last contact., Patient reported BC-specific QoL as measured by FACT–ES., ORR is defined as the percentage of patients who have achieved either a confirmed complete response or partial response., CBR is defined as the percentage of patients who have achieved either a confirmed complete response or partial response, or stable disease for at least 24 weeks from randomization., Frequency and severity of AEs graded according to the National Cancer Institute Common Terminology Criteria for Adverse Events (NCI-CTCAE) version 5.0., Dose reductions, dose delays, treatment interruptions, and treatment discontinuation rates.

Source: https://euclinicaltrials.eu/ctis-public/view/2023-504925-38-00